EU clinical trial 2023-508076-11-00: Pre-Operative Treatment in rEseCTable cOlon canceR (PROTECTOR/FIRE-10; AIO-KRK-0620; IAG-VO-0323) Prospective, randomized, open-label, multicenter Phase III trial to investigate the efficacy of preoperative systemic therapy in advanced colon cancer
Protocol code: PROTECTOR/FIRE-10
Sponsor: Charite Universitaetsmedizin Berlin KöR (Hospital/Clinic/Other health care facility). Phase: Therapeutic confirmatory (Phase III). Countries: Germany (ongoing, recruiting).
Therapeutic area(s): Diseases [C] - Digestive System Diseases [C06]
Gender: Female, Male. Age: 18-64 years, 65+ years. Enrolment: 714.
Status: Ongoing, recruiting. Start date (EU): 2025-04-01. Decision date: 2024-11-27. Results received: No. Last updated: 2026-07-30.

Condition(s): Colon cancer staged T3-4 and/or nodal positive by CT and/or MRI scan without distant metastases.
Product: OXALIPLATIN, CALCIUM FOLINATE, IRINOTECAN, FLUOROURACIL, CAPECITABINE, DISODIUM FOLINATE

Primary endpoint: Disease-free survival (DFS) - defined as no surgery, no resection, incomplete resection, disease recurrence (new metastases or local relapse) and death from any cause from the time of randomization. In case of no surgery,no resection, or incomplete resection (defined as R2 resection = macroscopic tumor rest), the timepoint of the respective event will be set to two weeks after randomization to avoid time-bias in favor of the experimental/neoadjuvant therapy arm.

Source: https://euclinicaltrials.eu/ctis-public/view/2023-508076-11-00